EU clinical trial 2023-509092-16-00: Precision therapy versus standard therapy in Acute Myeloid Leukaemia and Myelodysplastic syndrome in elderly (PALM) – a phase II randomized clinical trial
Protocol code: PALM
Sponsor: Akershus University Hospital (Hospital/Clinic/Other health care facility). Phase: Therapeutic exploratory (Phase II). Countries: Norway (ended).
Therapeutic area(s): Diseases [C] - Neoplasms [C04]; Health Care [N] - Health Care Economics and Organizations [N03]
Gender: Female, Male. Age: 65+ years. Enrolment: 33.
Status: Ended. End date (EU): 2025-11-27. Decision date: 2024-10-18. Results received: No. Last updated: 2024-10-18.

Condition(s): Chronic myelomonocyte leukemia, Myelodysplastic syndrome, Acute myeloid leukemia
Product: Dacogen 50 mg powder for concentrate for solution for infusion., Nexavar 200 mg film-coated tablets, Vepesid 50 mg kapsler, myke, Venclyxto 50 mg film-coated tablets, Tafinlar 75 mg hard capsules, Mekinist 2 mg film-coated tablets, Atorvastatin Accord 10 mg filmdrasjerte tabletter, Vidaza 25 mg/ml powder for suspension for injection, Hydroxyurea medac 500 mg kapsel, hard, Venclyxto 100 mg film-coated tablets

Primary endpoint: Cost-effectiveness of precison therapy, defined by the incremental costs per quality adjusted life-years gained (QALYs) based on measurements of Health-related quality of life (HRQoL) and total costs of treatment and follow-up

Source: https://euclinicaltrials.eu/ctis-public/view/2023-509092-16-00